EU clinical trial 2024-513465-39-00: Clinical Efficacy of oral Fosfomycin Trometamol and Cefixime in the Treatment of Acute Bacterial Prostatitis (CEFOSPROST): a comparative, randomized, open, multicenter trial.
Protocol code: CEFOSPROST
Sponsor: Fundacio Hospital Universitari Vall D’Hebron Institut De Recerca (Laboratory/Research/Testing facility). Phase: Therapeutic use (Phase IV). Countries: Spain (ongoing, recruiting).
Therapeutic area(s): Diseases [C] - Male Urogenital Diseases [C12]
Gender: Male. Age: 18-64 years, 65+ years. Enrolment: 276.
Status: Ongoing, recruiting. Start date (EU): 2024-12-04. Decision date: 2024-08-21. Results received: No. Last updated: 2026-04-24.

Condition(s): Acute bacterial prostatitis
Product: CEFIXIME, CIPROFLOXACIN HYDROCHLORIDE, FOSFOMYCIN

Primary endpoint: Clinical cure: patient alive with reduction of all initial local and systemic febrile UTI related symptoms and without additional systemic antibiotic therapy for UTI (except antibiotic prophylaxis) at 6-10 days post-end of treatment.

Source: https://euclinicaltrials.eu/ctis-public/view/2024-513465-39-00